EU clinical trial 2025-521295-60-00: Multiple Ascending Dose Study of LY4256984 in Participants with Sporadic Amyotrophic Lateral Sclerosis
Protocol code: J6I-MC-OWAA
Sponsor: Eli Lilly & Co. (Pharmaceutical company). Phase: Human Pharmacology (Phase I)- First administration to humans. Countries: Belgium (ongoing, recruiting), Spain (ongoing, recruiting), Netherlands (ongoing, recruiting), Germany (ongoing, recruiting).
Therapeutic area(s): Diseases [C] - Nervous System Diseases [C10]
Gender: Female, Male. Age: 18-64 years, 65+ years. Enrolment: 30.
Status: Ongoing, recruiting. Start date (EU): 2026-01-29. Decision date: 2025-09-02. Results received: No. Last updated: 2025-12-01.
Decision dates by country: NL: 2025-09-09, ES: 2025-09-03, BE: 2025-09-04, DE: 2025-09-02

Condition(s): Sporadic Amyotrophic Lateral Sclerosis

Source: https://euclinicaltrials.eu/ctis-public/view/2025-521295-60-00